EU clinical trial 2024-512493-98-00: Vaccination with Autologous Dendritic cells loaded with Autologous Tumour homogenate in Glioblastoma: a phase II Study (Combi G-Vax)
Protocol code: IRST191.05
Sponsor: Istituto Romagnolo Per Lo Studio Dei Tumori Dino Amadori IRST S.r.l. (Hospital/Clinic/Other health care facility). Phase: Therapeutic exploratory (Phase II). Countries: Italy (ongoing, recruiting).
Therapeutic area(s): Diseases [C] - Neoplasms [C04]
Gender: Female, Male. Age: 18-64 years, 65+ years. Enrolment: 28.
Status: Ongoing, recruiting. Start date (EU): 2021-03-25. Decision date: 2024-07-15. Results received: No. Last updated: 2024-07-15.

Condition(s): Glioblastoma
Product: Temozolomide SUN 5 mg hard capsules, Temozolomide SUN 250 mg hard capsules, Temozolomide SUN 20 mg hard capsules, DC-VACCINE_IRSTIRCCS, Temozolomide SUN 100 mg hard capsules

Primary endpoint: Progression free survival (PFS), measured as the proportion of patients without progression of disease at three months from leukapheresis, Proportion of patients experienced grade 3 or higher adverse events related to the study treatment
Endpoint(s): Evaluation of the prognostic role of a positive DTH test after at least four vaccine administrations, Overall survival (OS), Ability to enhance the proportion of circulating immune effectors specific for tumor antigens; evaluation of the persistence of an anti-tumor immune response; determination of plasma levels of a panel of inflammatory cytokines and proangiogenic factors; evaluation of the prognostic and predictive role of tumor antigen expression in tumor tissue; analysis of the prognostic and predictive role of immune cells in the peripheral blood and in the tumor microenvironment

Source: https://euclinicaltrials.eu/ctis-public/view/2024-512493-98-00